EU clinical trial 2023-504324-26-00: Randomized, Double Blind, Placebo Controlled "first-in-human" Study to Assess the Safety and Tolerability of Single Ascending Intravenous Doses and Multiple Intravenous Doses of RA0127 in Healthy Young Volunteers
Protocol code: RA0127-101
Sponsor: Remab Therapeutics S.L. (Pharmaceutical company). Phase: Human Pharmacology (Phase I)- First administration to humans. Countries: Spain (ongoing, recruiting).
Therapeutic area(s): Diseases [C] - Bacterial Infections and Mycoses [C01]
Gender: Female, Male. Age: 18-64 years. Enrolment: 40.
Status: Ongoing, recruiting. Start date (EU): 2025-05-20. Decision date: 2023-06-12. Results received: No. Last updated: 2025-09-05.

Condition(s): Prevention of infections caused by Gram-negative bacteria

Source: https://euclinicaltrials.eu/ctis-public/view/2023-504324-26-00